EU clinical trial 2024-514999-41-00: Multicenter open-label, phase II trial, to evaluate the efficacy and safety of nal-IRI for progressing brain metastases in patients with HER2-negative breast cancer.
Protocol code: MEDOPP107
Sponsor: Medica Scientia Innovation Research S.L. (Pharmaceutical company). Phase: Therapeutic exploratory (Phase II). Countries: Spain (ended).
Therapeutic area(s): Diseases [C] - Neoplasms [C04]
Gender: Female, Male. Age: 18-64 years, 65+ years. Enrolment: 56.
Status: Ended. Start date (EU): 2017-04-28. End date (EU): 2025-04-02. Decision date: 2024-10-14. Results received: Yes. Last updated: 2025-02-06.

Condition(s): HER2 negative metastatic breast cancer (MBC) with nervous system involvement and measurable metastases
Product: Onivyde pegylated liposomal 4.3 mg/ml concentrate for dispersion for infusion

Primary endpoint: ORR-IC determined using modified RANO- BM criteria with central confirmation by a volumetric parameter in patients with progressive brain metastases. According to these criteria Complete response (CR) will be defined as the disappearance of all CNS target lesions, no new lesions, no corticosteroids; stable or improved clinically., Partial response (PR) will be defined as a decreased of at least 30% in the sum longest diameter (LD) of CNS target lesions, taking as reference the baseline sum LD; no new lesions; no corticosteroids; stable or improved clinically). CR and PR (≥30% unidimensional reduction of CNS lesions) must be sustained for at least 4 weeks or centrally confirmed according to volumetric parameter (≥65% volumetric reduction of CNS lesions).
Endpoint(s): ORR will be defined according to a volumetric parameter defined as the proportion of patients with a reduction in tumor burden (>65% volumetric reduction of CNS lesion(s) in the absence of increasing steroid use, progressive neurologic symptoms and/or signs or progressive extra CNS disease) and to RECIST 1.1 criteria. In patients with progressing brain metastases. The volumetric parameter will be centrally reviewed., ORR will be defined as the percentage of patients who experience a CR, PR determined locally by the investigator, using RECIST criteria v.1.1 (for IC, EC, and overall lesions) in patients with progressing brain metastases and in all patients with CNS involvement., CBR will be defined as the percentage of patients who experience a CR, PR or stable disease for at least 12 weeks determined locally by the investigator, using RANO-BM criteria (for IC lesions) and RECIST criteria v.1.1 (for IC, EC, and overall lesions) in patients with progressing brain metastases and in all patients with CNS involvement., DCR will be defined as the percentage of patients who experience a CR, PR or stable disease determined locally by the investigator, using RANO-BM criteria (for IC lesions) and RECIST criteria v.1.1 (for IC, EC, and overall lesions) in patients with progressing brain metastases and in all patients with CNS involvement., PFS will be defined as the time from treatment initiation to the first occurrence of disease progression or death from any cause, whichever occurs first, determined locally by the investigator, using RECIST criteria v.1.1 in patients with progressing brain metastases and in all patients with CNS involvement., TTR will be defined as the time from treatment initiation to time of the first objective tumor response observed in patients who achieved a CR or PR, determined locally by the investigator, using RANO-BM criteria (for IC lesions) and RECIST criteria v.1.1 (for IC, EC, and overall lesions) in patients with progressing brain metastases and in all patients with CNS involvement., DoR will be defined as the time from the first occurrence of a documented objective response to disease progression or death from any cause, whichever occurs first, determined locally by the investigator, using RANO-BM criteria (for IC lesions) and RECIST criteria v.1.1 (for IC, EC, and overall lesions) in patients with progressing brain metastases and in all patients with CNS involvement., MTS from baseline in the size of target tumor lesions, defined as the biggest decrease, or smallest increase if no decrease observed, determined locally by the investigator, using RANO-BM criteria (for IC lesions) and RECIST criteria v.1.1 (for IC, EC, and overall lesions) in patients with progressing brain metastases and in all patients with CNS involvement., OS, defined as the time from treatment initiation to death from any cause, and determined locally by the investigator in patients with progressing brain metastases and in all patients with CNS involvement., Patient safety and AEs will be determined locally by the investigator, using the CTCAE v4 in all patients with CNS involvement., To assess ORR, CBR, DCR, TTR, DOR, PFS, and OS of nal-IRI in patients with stable brain metastases.

Source: https://euclinicaltrials.eu/ctis-public/view/2024-514999-41-00